EU clinical trial 2024-517925-25-00: LONG-TERM INTERVENTIONAL FOLLOW-UP STUDY UP TO 4 YEARS OF AGE OF CHILDREN WITH PRADER-WILLI SYNDROME INCLUDED IN THE OTBB3 CLINICAL TRIAL AND COMPARISON WITH AN UNTREATED COHORT OF CHILDREN WITH PRADER-WILLI SYNDROME (OTBB3 FOLLOW-UP)
Protocol code: RC31/20/0421
Sponsor: Centre Hospitalier Universitaire De Toulouse (Hospital/Clinic/Other health care facility). Phase: Therapeutic exploratory (Phase II). Countries: France (ended).
Therapeutic area(s): Diseases [C] - Nutritional and Metabolic Diseases [C18]
Gender: Female, Male. Age: 0-17 years. Enrolment: 65.
Status: Ended. End date (EU): 2025-04-29. Decision date: 2024-12-17. Results received: No. Last updated: 2024-12-17.

Condition(s): prader-willi syndrome
Product: Otwillo 44.44 IU/mL, nasal spray solution

Primary endpoint: The number and percentage of patients with adverse events (AEs) and serious adverse events (SAEs);, The occurrence of the main comorbidities, The occurrence of medications, surgery and rehabilitations by collecting type, age at start and stop, dosing or frequency.

Source: https://euclinicaltrials.eu/ctis-public/view/2024-517925-25-00